EU clinical trial 2024-515178-28-00: Evaluation of Multiparametric dynamic whole-body 68Ga-PSMA PET imaging for Hepatocellular Carcinoma recurrence. HIMIKO study.
Protocol code: RC24_0482
Sponsor: Centre Hospitalier Universitaire De Nantes (Hospital/Clinic/Other health care facility). Phase: Phase I and Phase II (Integrated)- Other. Countries: France (ongoing, recruiting).
Therapeutic area(s): Diseases [C] - Stomatognathic Diseases [C07]
Gender: Female, Male. Age: 18-64 years, 65+ years. Enrolment: 40.
Status: Ongoing, recruiting. Start date (EU): 2025-09-23. Decision date: 2025-05-06. Results received: No. Last updated: 2026-07-03.

Condition(s): Hepatocellular carcinoma

Source: https://euclinicaltrials.eu/ctis-public/view/2024-515178-28-00